EU clinical trial 2025-524278-40-00: Fludarabine exposure in patients undergoing Fludarabine based lymphodepletion prior to CAR-T cell therapy
Protocol code: FLU-CART
Sponsor: Universitair Ziekenhuis Gent (Hospital/Clinic/Other health care facility). Phase: Therapeutic use (Phase IV). Countries: Belgium (ongoing, recruiting).
Therapeutic area(s): Diseases [C] - Hemic and Lymphatic Diseases [C15]; Analytical, Diagnostic and Therapeutic Techniques and Equipment [E] - Therapeutics [E02]
Gender: Female, Male. Age: 18-64 years, 65+ years. Enrolment: 75.
Status: Ongoing, recruiting. Start date (EU): 2026-07-24. Decision date: 2026-03-23. Results received: No. Last updated: 2026-05-18.

Condition(s): Patients undergoing Fludarabine based lymphodepletion prior to CAR-T cell therapy, for hematological malignancy
Product: FLUDARABINE TEVA 25 mg/ml KONZENTRAT ZUR HERSTELLUNG EINER INJEKTIONS- ODER INFUSIONSLOESUNG, CARVYKTI 3.2 × 10^6 – 1 × 10^8 cells dispersion for infusion, Fludarabine Teva 25 mg/ml solution à diluer pour injection ou perfusion, YESCARTA 0.4 – 2 x 10e8 cells dispersion for infusion, Tecartus 0.4 - 2 x 10e8 cells dispersion for infusion, Kymriah 1.2 x 10^6 – 6 x 10^8 cells dispersion for infusion, Fludarabine Teva 25 mg/ml concentraat voor oplossing voor injectie of infusie, Endoxan 1000 mg, poeder voor oplossing voor injectie, Endoxan 500 mg, poeder voor oplossing voor injectie

Primary endpoint: Area under concentration time curve (AUC) of F-Ara-A from time 0 to infinity, Coefficient of variation (CV) for plasma concentrations of F-Ara-A, Maximum observed concentration (Cmax)
Endpoint(s): Patient covariates: - Sex - Creatinine - Creatinine clearance - Cystatine C - Cystatine C clearance - Actual body weight (ABW) - Ideal body weight (IBW) - Body mass index (BMI) - Body surface aera (BSA); To be assessed after the last included patient has finished LDC.

Source: https://euclinicaltrials.eu/ctis-public/view/2025-524278-40-00